EU clinical trial 2025-522546-52-00: Sustained-release oral morphine to alleviate persistent dyspnea in patients with chronic respiratory insufficiency due to amyotrophic lateral sclerosis outside the administration of ventilatory assistance: prospective multicenter randomized, placebo-controlled study, parallel arms. (OPIDYS-ALS).
Protocol code: APHP 230842
Sponsor: Assistance Publique Hopitaux De Paris (Hospital/Clinic/Other health care facility). Phase: Therapeutic confirmatory (Phase III). Countries: France (authorised, recruitment pending).
Therapeutic area(s): Diseases [C] - Respiratory Tract Diseases [C08]; Diseases [C] - Musculoskeletal Diseases [C05]
Gender: Female, Male. Age: 18-64 years, 65+ years. Enrolment: 160.
Status: Authorised, recruitment pending. Decision date: 2026-02-13. Results received: No. Last updated: 2026-02-13.

Condition(s): patients with chronic respiratory insufficiency due to amyotrophic lateral sclerosis.
Product: MORPHINE SULFATE, Placebo tablets morphine sulfate 10mg

Primary endpoint: The primary endpoint of the study will be the change in intensity of dyspnea unpleasantness during the worst dyspneic episode experienced in the previous 24 hours, assessed at Day 7 and four weeks after inclusion in the study
Endpoint(s): Endpoints evaluating the efficacy of the treatment on dyspnea: The change in the intensity of dyspnea unpleasantness NRS evaluation, The evolution of dyspnea unpleasantness, The description of dyspnea according to the "Dyspnea ALS-15, The multidimensional description of dyspnea according to the Multidimensional Dyspnea Profile (MDP), The intensity of dyspnea-related anxiety evaluated on a 0-10 NRS, The time spent daily under mechanical ventilation (mechanical ventilator recordings),, Endpoints evaluating the efficacy of the treatment on outcomes other than dyspnea and on quality of life, The intensity of pain evaluated on a 0-10 NRS, Health-related quality of life (HRQoL), evaluated,in a general manner, using the 12-Item Short-Form Health Survey (SF12) , Sleep quality evaluated using the Pittsburgh Sleep Quality Index (PSQI), Endpoints evaluating the impact of the treatment on the patients' closest informal caregiver: The intensity of general anxiety evaluated on a 0-10 NRS, The intensity of dyspnea-related anxiety evaluated on a 0-10 NRS, The intensity of the burden of care weighing on the patients' designated closest relatives, if any, using the revised 22-item Zarit Burden Interview (ZBI), The quality of life of the patients' designated closest relatives, if any, using the questionnaire (WHOQOL-BREF)., Endpoints evaluating the tolerance of the treatment : The incidence of adverse events will be evaluated during each interaction with the graded according to CTCAE, . respiratory frequency during unassisted breathing, transcutaneous pulsed oxygen saturation during unassisted breathing, and arterial blood gases during unassisted breathing, Opioid-induced constipation. Opioid-induced constipation will be assessed as a predefined secondary endpoint related to treatment tolerance

Source: https://euclinicaltrials.eu/ctis-public/view/2025-522546-52-00